EU clinical trial 2024-516722-59-00: A Phase 1-2 Master Protocol to Study Intravenous ATTR-01 in Adult Participants with Select Epithelial Solid Tumours Under Multiple Sub-protocols (ATTEST)
Protocol code: ATTR-01-01
Sponsor: Accession Therapeutics Limited (Pharmaceutical company). Phase: Phase I and Phase II (Integrated)- First administration to humans. Countries: Spain (ongoing, recruiting).
Therapeutic area(s): Diseases [C] - Neoplasms [C04]
Gender: Female, Male. Age: 18-64 years, 65+ years. Enrolment: 30.
Status: Ongoing, recruiting. Start date (EU): 2026-01-23. Decision date: 2025-04-30. Results received: No. Last updated: 2026-06-15.

Condition(s): Select Epithelial Solid Tumours
Product: ATTR-01

Primary endpoint: Incidence of AEs, serious adverse events (SAEs), dose limiting toxicities (DLTs), discontinuation of investigational product(s) due to toxicity and clinically significant alterations in vital signs or other clinical safety assessments, Objective Response Rate (ORR) from first scan onwards, per RECIST V1.1, Duration of Response (DoR)
Endpoint(s): Per RECIST V1.1 from first scan onwards: • Disease Control Rate (DCR), Per RECIST V1.1 from first scan onwards: • Time To Response (TTR), Per RECIST V1.1 from first scan onwards: • Progression Free Survival (PFS), Per RECIST V1.1 from first scan onwards: • Overall Survival (OS), Per RECIST V1.1 from first scan onwards: • Maximum reduction in tumour size, SP A only: • ORR from first scan onwards, per RECIST V1.1, SP A only: • Duration of Response (DoR), ATTR-01 viral persistence/blood concentrations, ATTR-01 immunogenicity/anti-ATTR-01 antibodies

Source: https://euclinicaltrials.eu/ctis-public/view/2024-516722-59-00